EU clinical trial 2024-517325-43-00: IFM2024-06 : A multi-center, open-label, phase 2 randomized study of elranatamab plus lenalidomide versus daratumumab plus lenalidomide as post transplantation maintenance therapy in patients with newly-diagnosed myeloma
Protocol code: RC23_0603
Sponsor: Centre Hospitalier Universitaire De Nantes (Hospital/Clinic/Other health care facility). Phase: Therapeutic exploratory (Phase II). Countries: France (ongoing, recruiting).
Therapeutic area(s): Not possible to specify
Gender: Female, Male. Age: 18-64 years, 65+ years. Enrolment: 176.
Status: Ongoing, recruiting. Start date (EU): 2025-06-19. Decision date: 2025-03-28. Results received: No. Last updated: 2026-07-10.

Condition(s): multiple myeloma
Product: LENALIDOMIDE, DARATUMUMAB, LENALIDOMIDE, ELRANATAMAB

Primary endpoint: The primary endpoint will be the MRD negativity rate (10-6, NGS) status at one year (+/- 1 month) after randomization .
Endpoint(s): rate of MRD [-] status at one year (+/-1month) after randomisation, Presence and severity of TEAEs defined by NCI CTCAE Version 5.0 (Number of TEAEs), except for CRS and ICANS, which will be assessed based on ASTCT guidelines. Time frame : Throughout study, Rate of MRD [-] status at two years (+/-1month) after randomization. Time frame: MRD assessment at 2 years (+/-1month) after completion, Rate of patients with MRD [-] status during at least 12 months (at least two consecutive times) Time frame : 1 year, 2 years, The rate of complete response or better as defined by IMWG 2016 Time frame : at any time during the study, OS: time from randomisation to the date of death due to any cause. Subjects alive will be censored at the last date of follow-up., Progression-free survival, defined as the time from randomization to the first occurrence of PD, or death from any cause, whichever occurs first. Subjects alive and for whom disease progression has not been observed will be censored at the last date of follow-up., PFS2: time from randomization to either second line PD (assessed by investigator on the first subsequent line of antimyeloma therapy) or death, whichever occurs first. Subjects alive and for whom a second disease progression has not been observed will be censored at the last date of follow-up., Ability of return to work assessed by a specific questionnaire Time frame: At the end of follow-up, • Outcome: MRD status at 1 year post-randomisation • Response: Complete response at any time during study • Value of biological prognostic factors (at diagnosis), such as: • ISS stage • Cytogenetics as del(17p), t(4;14), t(14;16), t(14;20), gain(1q), TP53 and del(1p32) • Time frame : at diagnosis, Change in EQ-5D-5L and EORTC QC30 score over time Time frame : Screening, Maintenance C1D1, D1 every 3rd cycle, EOT, FU before PD)

Source: https://euclinicaltrials.eu/ctis-public/view/2024-517325-43-00